EU clinical trial 2023-508372-10-00: A Phase 2 Randomized Study of Relatlimab plus Nivolumab in Combination with Chemotherapy vs. Nivolumab in Combination with Chemotherapy as First Line Treatment for Participants with Stage IV or Recurrent Non-small Cell Lung Cancer (NSCLC)
Protocol code: CA224-104
Sponsor: Bristol-Myers Squibb Services Unlimited Company (Pharmaceutical company). Phase: Therapeutic exploratory (Phase II). Countries: Poland (ended), Ireland (ended), Spain (ended), Germany (ended), Romania (ended), France (ended), Netherlands (ended), Belgium (ended), Italy (ended).
Therapeutic area(s): Diseases [C] - Neoplasms [C04]
Gender: Female, Male. Age: 18-64 years, 65+ years. Enrolment: 288.
Status: Ended. Start date (EU): 2021-05-19. End date (EU): 2026-02-11. End date: 2026-05-06. Decision date: 2024-05-06. Results received: No. Last updated: 2026-06-30.
Decision dates by country: IT: 2024-05-13, NL: 2024-05-06, PL: 2024-05-07, DE: 2024-05-13, ES: 2024-05-13, IE: 2024-05-07, BE: 2024-05-07, FR: 2024-06-12, RO: 2024-05-13

Condition(s): Non small Cell Lung cancer, Non Small Cell Lung Cancer, Non Small Cell Lung Cancer, Non Small Cell Lung Cancer
Product: Relatlimab, CISPLATIN, PACLITAXEL ALBUMIN-BOUND, CARBOPLATIN, PEMETREXED DISODIUM, PACLITAXEL, OPDIVO 10 mg/mL concentrate for solution for infusion.

Primary endpoint: Part 1 •TRAEs leading to discontinuation within 12 weeks after the first dose, Part 2 •ORR per RECIST v1.1 by BICR
Endpoint(s): Part 1 •Incidence of TRAEs leading to discontinuation, AEs, SAEs, and select AEs, Part 2 •PFS per RECIST v1.1 by BICR

Source: https://euclinicaltrials.eu/ctis-public/view/2023-508372-10-00